EU clinical trial 2024-518391-31-00: A randomized, double-blinded, placebo-controlled study of Rituximab in patients with Psychosis and/or Obsessive Compulsive Disorder, with an indication of immune system involvement.
Protocol code: RA-P-OCD-01
Sponsor: Region Uppsala (Hospital/Clinic/Other health care facility). Phase: Therapeutic exploratory (Phase II). Countries: Sweden (ongoing, recruiting).
Therapeutic area(s): Psychiatry and Psychology [F] - Mental Disorders [F03]
Gender: Female, Male. Age: 18-64 years. Enrolment: 40.
Status: Ongoing, recruiting. Start date (EU): 2024-11-05. Decision date: 2024-11-05. Results received: No. Last updated: 2024-11-14.

Condition(s): Psychosis and or Obsessive Compulsive Disorder, with an indication of immune system involvement
Product: RITUXIMAB

Primary endpoint: The clinical efficacy of Rituximab treatment will be evaluated by calculating the average difference between BPRS scores at baseline and main-evaluation (8-month) and comparing it between the treatment-first and the placebo-first group.
Endpoint(s): 1. The amelioration in psychiatric symptomatology will be assessed by following the psychiatric rating scales: o CGI o WHODAS, o EQ-VAS, o Y-BOCS o BFCS, 2. Improvement in executive functions, will be assessed by following neuropsychiatric tests: o Neuropsychological tests o Mismatch negativity, 3. The amelioration of neurological symptoms will be assessed by performing complete, video-recorded neurological exams. This procedure is described in section 11., 4. The longevity of psychiatric, neurological and executive improvements will be examined by the psychiatric ratings scales named in 1. and blood samples every 4 months up to 16 months, and in addition to that a thorough neurological exam, the executive tests named in 2. and CSF samples every 8 months up to 16 months., 5. The safety of Rituximab treatment will be assessed by adverse events monitoring and questionnaires described in detail in section 12.

Source: https://euclinicaltrials.eu/ctis-public/view/2024-518391-31-00